EU clinical trial 2023-509777-23-00: E. coli Urinary Tract Infection Study
Protocol code: PP-EC-001
Sponsor: Phagenix (Pharmaceutical company). Phase: Human Pharmacology (Phase I)- First administration to humans. Countries: France (authorised, recruitment pending).
Therapeutic area(s): Diseases [C] - Bacterial Infections and Mycoses [C01]
Gender: Female, Male. Age: 18-64 years, 65+ years. Enrolment: 36.
Status: Authorised, recruitment pending. Decision date: 2024-05-06. Results received: No. Last updated: 2026-05-21.

Condition(s): Bacterial urinary infection

Source: https://euclinicaltrials.eu/ctis-public/view/2023-509777-23-00